EU clinical trial 2023-506166-31-01: VAXXAIR TRIAL: In-depth Immunological Analysis of Airway Immunity following Nasal Live Attenuated and Intramuscular Influenza Vaccine A randomized controlled trial
Protocol code: VAXXAIR TRIAL
Sponsor: Gentofte Hospital (Hospital/Clinic/Other health care facility). Phase: Therapeutic use (Phase IV). Countries: Denmark (ended).
Therapeutic area(s): Diseases [C] - Virus Diseases [C02]; Diseases [C] - Respiratory Tract Diseases [C08]
Gender: Female, Male. Age: 18-64 years. Enrolment: 55.
Status: Ended. Start date (EU): 2024-12-23. End date (EU): 2026-07-27. Decision date: 2024-01-16. Results received: No. Last updated: 2025-11-27.

Condition(s): Influenza
Product: Vaxigrip suspension for injection in pre-filled syringe. Trivalent influenza vaccine (split virion, inactivated)., Fluenz nasal spray suspension Influenza vaccine (live attenuated, nasal), Fluenz Placebo

Primary endpoint: Cellular: Antigen activated CD4+ T-lymphocytes measured at –14, day +7 day +28 [+/-5 days]and day +90 [+/-5 days] after vaccination., Humoral: Number of participants with ≥-4-fold rise in mucosal antibody titer against each vaccine virus haemagglutinin antigens vaccine-specific antibody (IgG and IgA) titers in respiratory secretions measured using antibody titer measured at –14, day +7 day +28 [+/-5 days]and day +90 [+/-5 days] after vaccination
Endpoint(s): Cellular: Quantification and characterization of leukocyte cell subsets, incl T- and B-cell subsets and activation patterns, using highly standardized flowcytometry in combination with single cell RNAsequencing (scRNAseq) analysis coupled with single cell surface marker profiling (CITEseq or similar platform) for in-depth characterization of immune cell subsets measured at –14, day +7 day +28 [+/-5 days]and day +90 [+/-5 days] after vaccination, Humoral: Number of participants with ≥-4-fold rise in serum antibody titers against each vaccine virus haemagglutinin antigens vaccine-specific antibody (IgG) titers in serum measured using antibody titer measured measured at –14, day +7 day +28 [+/-5 days]and day +90 [+/-5 days] after vaccination.

Source: https://euclinicaltrials.eu/ctis-public/view/2023-506166-31-01